EU clinical trial 2024-513901-30-00: Long-term Follow-up of Subjects With Sickle Cell Disease Treated With Ex Vivo Gene Therapy Using Autologous Hematopoietic Stem Cells Transduced With a Lentiviral Vector
Protocol code: LTF-307
Sponsor: Genetix Biotherapeutics Inc. (Pharmaceutical company). Phase: Therapeutic confirmatory (Phase III). Countries: France (ongoing, recruiting).
Therapeutic area(s): Diseases [C] - Hemic and Lymphatic Diseases [C15]
Gender: Female, Male. Age: 0-17 years, 18-64 years. Enrolment: 3.
Status: Ongoing, recruiting. Start date (EU): 2020-11-03. Decision date: 2024-06-25. Results received: No. Last updated: 2026-07-03.

Condition(s): Sickle-cell disease
Product: LentiGlobin BB305 Drug Product for Sickle Cell Disease

Primary endpoint: The number of subjects with immune-related AEs (e.g., autoimmune disorders, graft-versus-host disease, opportunistic infections, HIV), The number of subjects with new or worsening hematologic disorders, The number of subjects with new or worsening neurologic disorders, The number of subjects with malignancies
Endpoint(s): Vaso-Occlusive Events Endpoints: The proportion of subjects with complete resolution of severe VOEs (sVOE-CR) over time through Year 15, The proportion of subjects with complete resolution of VOEs (VOE-CR) over time through Year 15, Annualized number of severe VOEs over time through Year 15, Annualized number of VOEs over time through Year 15, Change from parent study baseline in annualized number of severe VOEs over time through Year 15, Hematologic Endpoints: Assessment of the following over time post-drug product infusion through Year 15: − total Hb − non-transfused total Hb − HbS percentage of non-transfused total Hb − HbAT87Q percentage of non-transfused total Hb − non-HbS percentage of non-transfused total Hb, Change from parent study baseline through Year 15 in the following hemolysis markers: absolute reticulocyte count, % reticulocytes/erythrocytes, total bilirubin, indirect bilirubin, haptoglobin, and lactate dehydrogenase, Change from parent study baseline through Year 15 in the following markers of iron stores: serum ferritin and liver iron content

Source: https://euclinicaltrials.eu/ctis-public/view/2024-513901-30-00